EU clinical trial 2023-510046-25-00: A first in human Phase 1/2 open-label, multicenter, dose escalation and expansion study of PRS-344/S095012 in patients with solid tumors.
Protocol code: CL1-95012-001
Sponsor: Institut De Recherches Internationales Servier IRIS (Pharmaceutical company). Phase: Phase I and Phase II (Integrated)- First administration to humans. Countries: Spain (ended), France (ended), Belgium (ended).
Therapeutic area(s): Diseases [C] - Neoplasms [C04]
Gender: Female, Male. Age: 18-64 years, 65+ years. Enrolment: 102.
Status: Ended. Start date (EU): 2021-09-02. End date (EU): 2025-04-01. End date: 2025-04-02. Decision date: 2024-06-11. Results received: Yes. Last updated: 2024-10-30.
Decision dates by country: BE: 2024-06-11, FR: 2024-06-17, ES: 2024-06-13

Condition(s): Soild Tumors
Product: S95012 concentrate solution for infusion 400mg/ 16 ml, Gazyvaro 1,000 mg concentrate for solution for infusion.

Primary endpoint: Phase 1: Incidence of DLTs, Phase 1: Incidence and severity of adverse events (AEs), Phase 1: Discontinuation of study treatment due to an AE, Phase 1: Laboratory, electrocardiogram (ECG) and vital sign measurements, Phase 2: Arms 1 and 2: OR as per central assessment according to RECIST v1.1 criteriaper central assessment, Phase 2: Arm 3: OR as per central assessment and composite response criteria (digital medical photography and/or imaging as per RECIST v1.1)
Endpoint(s): Phase 1: Serum PK parameters of PRS-344/S095012, Phase 1: Detection of antidrug antibodies (ADA) against PRS-344/S095012 and their titration when applicable, Phase 1: Objective Response (OR): Defined as Complete Response (CR) plus Partial Response (PR), Phase 1: Duration of Response (DoR): defined as the time from first demonstration of response to progression or death, whichever occurs first, Phase 1: Progression-free Survival (PFS): Defined as the time from the first dose of treatment to first documented disease progression or death due to any cause, whichever occurs first, Phase 1: Overall Survival (OS): Defined as the time from first dose of study drug to death due to any cause, Phase 2: All arms: OR as per investigator assessment, Disease Control (DC), DoR, PFS, OS, Time to Response (TTR), Phase 2: AEs, serious adverse events (SAEs), Laboratory, ECG, vital signs, Phase 2: Serum concentrations of PRS-344/S095012, Phase 2: Detection of ADA against PRS-344/S095012 and their titration when applicable

Source: https://euclinicaltrials.eu/ctis-public/view/2023-510046-25-00